EU clinical trial 2024-518862-28-00: A phase II/III multi-centre, open-label, parallel group study to prove the non-inferiority of safety and efficacy of Metronidazole/Neomycin Sulfate/ Nystatin, 500mg/ 65.000UI/100.000UI pessaries (Antibiotice SA) versus Tergynan® vaginal tablets (Bouchara–Recordati Laboratories) in the treatment of specific and non-specific vaginitis
Protocol code: NNMAIS 01/2021
Sponsor: Antibiotice S.A. (Pharmaceutical company). Phase: Phase II and Phase III (Integrated). Countries: Romania (temporarily halted).
Therapeutic area(s): Diseases [C] - Female Urogenital Diseases and Pregnancy Complications [C13]; Diseases [C] - Bacterial Infections and Mycoses [C01]
Gender: Female. Age: 18-64 years. Enrolment: 80.
Status: Temporarily halted. Start date (EU): 2024-11-19. Decision date: 2024-11-18. Results received: No. Last updated: 2024-11-18.

Condition(s): female patients with bacterial vaginosis (BV), respectively vulvovaginal candidiasis (VVC)
Product: Metronidazole/Neomycin sulfate/Nystatin 500 mg/65000 IU/100000 IU, pessaries, TERGYNAN, comprimé vaginal

Primary endpoint: Proportion of participants with clinical cure at V2 assessed on BV, respectively VVC group (on each treatment arm). Clinical cure is defined as: a. a score of zero (0) for any sign and symptom scored as 1–2 at baseline; or a score of 0–1 for any sign and symptom scored as 3 at baseline and without the need for further treatment at the discretion of the research clinician) among participants with VVC at baseline, b. absence of all of the following 3 Amsel criteria: Thin, off white, yellowish, mil
Endpoint(s): Proportion of participants with microbiological/mycological cure at V2 assessed on BV, respectively VVC group (on each treatment arm) a. Microbiologic cure of BV is defined as a Nugent score of 0-3 b. Mycological cure of VVC is defined as negative Candida culture., Therapeutic cure defined as combination between clinical cure and microbiologic/mycological cure for VVC, respectively BV at V2 (on each treatment arm), Proportion of participants reporting urogenital AEs following the first dose of the study product through V2 among participants with BV ( on each treatment arm)., Proportion of participants reporting urogenital AEs following the first dose of the study product through V2 among participants with VVC (on each treatment arm)., Proportion of participants reporting serious adverse events (SAEs) considered product-related following the first dose of the study product through V3 among participants with BV (on each treatment arm)., Proportion of participants reporting serious adverse events (SAEs) considered product-related following the first dose of the study product through V3 among participants with VVC (on each treatment arm)., The proportion of participants experiencing symptom relief (at least one day free of all symptoms) as assessed by the participant. [ Time Frame: Day 1-10], The proportion of participants who need additional treatment per physician opinion following initiation of study treatment and through the final study visit. [Time Frame: Day 1-10], The median time (time defined as earliest time point of reported symptom resolution) to symptom relief (at least one day free of all symptoms) as assessed by the participant. [Time Frame: Day 1-10], Proportion of participants who need additional treatment per physician opinion following initiation of study treatment and through the final study visit., Sustainability of therapeutic cure on each treatment arm from V2 to V3

Source: https://euclinicaltrials.eu/ctis-public/view/2024-518862-28-00